EU clinical trial 2024-515603-19-01: Phase II study to evaluate the efficacy of 12-month neoadjuvant chemotherapy in terms of disease-free survival in patients with localized digestive neuroendocrine carcinomas - NEONEC D19-01
Protocol code: NEONEC D19-01
Sponsor: Association Gercor (Laboratory/Research/Testing facility). Phase: Therapeutic exploratory (Phase II). Countries: France (authorised, recruitment pending).
Therapeutic area(s): Diseases [C] - Neoplasms [C04]
Gender: Female, Male. Age: 18-64 years, 65+ years. Enrolment: 78.
Status: Authorised, recruitment pending. Decision date: 2025-01-23. Results received: No. Last updated: 2025-10-14.

Condition(s): Localized digestive Neuroendocrine Carcinomas
Product: ETOPOSIDE VIATRIS 20 mg/ml, solution à diluer pour perfusion, CARBOPLATINE ACCORD 10 mg/ml, solution pour perfusion, CISPLATINE ACCORD 1 mg/ml, solution à diluer pour perfusion

Primary endpoint: 12-month RFS (relapse-free survival without locale or metastatic relapse and without death) for NEC patients receiving neoadjuvant chemotherapy, 12-month RFS in CNE patients undergoing surgery
Endpoint(s): Pre-operative response rate or prior radiochemotherapy response rate according to RECIST 1.1,, Rate of patients who do not benefit from surgery or radiochemotherapy, Rate of patients operated after neoadjuvant chemotherapy or receiving radiochemotherapy (if appropriate),, Degree of histological response (tumor regression grade [TRG]),, Overall survival (OS),, Description and the treatment regimens feasibility,, Collection of adverse events (AEs) according to National Cancer Institute Common Terminology Criteria for Adverse Toxicity Study (NCI CTCAE) version 5.0 for neoadjuvant treatment and post surgery, Biomarkers analysis – immunohistochemical analysis of the most specific markers of NEC (CD56, chromogranin A/B, synaptophysin, TTF1, DLL3, ASCL1, NOTCH, p53, p16 and Rb, possible best response to platinum-etoposide-based chemotherapy - if the expression of Rb is lost), and determination of the microsatellite instability (MSI) status. Comprehensive analysis of a panel of genes especially including RAS, RAF, HER2 or anti-EGFR, AKT, Pi3KCA, MET, and ALK-EML4 translocation will be also performed., ctDNA analysis: samples at Baseline and before surgery

Source: https://euclinicaltrials.eu/ctis-public/view/2024-515603-19-01